EU clinical trial 2022-502593-17-00: A Randomized, Open-label, Phase 3 Study of Sacituzumab Govitecan Versus Treatment of Physician’s Choice in Patients With Hormone Receptor-Positive (HR+)/Human Epidermal Growth Factor Receptor 2 Negative (HER2−) (HER2 IHC0 or HER2-low [IHC 1+, IHC 2+/ISH−]) Inoperable, Locally Advanced, or Metastatic Breast Cancer and Have Received Endocrine Therapy
Protocol code: GS-US-598-6168
Sponsor: Gilead Sciences Inc. (Pharmaceutical company). Phase: Therapeutic confirmatory (Phase III). Countries: Belgium (ongoing, recruitment ended), Italy (ongoing, recruitment ended), Portugal (ongoing, recruitment ended), Czechia (ongoing, recruitment ended), Austria (ongoing, recruitment ended), France (ongoing, recruitment ended), Germany (ongoing, recruitment ended), Greece (ongoing, recruitment ended), Hungary (ongoing, recruitment ended), Poland (ongoing, recruitment ended), Spain (ongoing, recruitment ended).
Therapeutic area(s): Diseases [C] - Neoplasms [C04]
Gender: Female, Male. Age: 18-64 years, 65+ years. Enrolment: 428.
Status: Ongoing, recruitment ended. Start date (EU): 2023-09-19. Decision date: 2023-08-21. Results received: No. Last updated: 2026-05-11.
Decision dates by country: PL: 2023-08-28, IT: 2023-08-21, FR: 2023-08-23, ES: 2023-08-25, DE: 2023-08-23, HU: 2023-08-28, AT: 2023-08-21, CZ: 2023-08-21, BE: 2023-08-21, GR: 2023-08-25, PT: 2023-08-21

Condition(s): Locally advanced or metastatic hormone receptor (HR)-positive, human epidermal growth factor receptor 2 (HER2)-negative breast cancer in patients who have received an endocrine-based regimen
Product: Trodelvy 200 mg powder for concentrate for solution for infusion., Xeloda 500 mg film-coated tablets, Paclitaxel 6 mg/ml concentrate for solution for infusion, Abraxane 5 mg/ml powder for dispersion for infusion., Xeloda 150 mg film-coated tablets, Abraxane 5 mg/ml powder for dispersion for infusion.

Primary endpoint: PFS is the time from the date of randomization until the date of first objective progressive disease (PD) as assessed by blinded independent central review (BICR) per Response Evaluation Criteria in Solid Tumors Version 1.1 (RECIST v1.1), or death from any cause, whichever comes first
Endpoint(s): OS is the time from randomization until the date of death from any cause, ORR is defined as the percentage of patients who have achieved a complete response (CR) or partial response (PR) that is confirmed at least 4 weeks after initial documentation of response as assessed by BICR per RECIST v1.1, Change from baseline in the physical functioning domain at Week 16, TTD of Global Health Status/QoL domain of the EORTC QLQ-C30 is defined as the time from date of randomization to the first time a patient experienced change from baseline equal or greater than the pre-specified threshold value for worsening or death, PFS is the time from the date of randomization until the date of first objective PD as assessed by the investigator per RECIST v1.1, or death from any cause, whichever comes first, ORR is defined as the percentage of patients who have achieved CR or PR that is confirmed at least 4 weeks after initial documentation of response as assessed by the investigator per RECIST v1.1, DOR is defined as the time from the first documentation of CR or PR to the earlier of the first documentation of objective PD or death from any cause (whichever comes first) as assessed by BICR and the investigator per RECIST v1.1, The incidence of adverse events (AEs) and serious adverse events (SAEs), Percentage of patients who experience clinically significant laboratory and/or vital sign abnormalities

Source: https://euclinicaltrials.eu/ctis-public/view/2022-502593-17-00